EU clinical trial 2024-511068-10-00: A randomized, double-blind, placebo controlled, 3-arm multicenter phase 3 study to assess the efficacy and safety of ianalumab in patients with active Sjögren’s syndrome (NEPTUNUS-2)
Protocol code: CVAY736A2302
Sponsor: Novartis Pharma AG (Pharmaceutical company). Phase: Therapeutic confirmatory (Phase III). Countries: Sweden (ended), Poland (ended), Spain (ended), Italy (ended), Hungary (ended), Germany (ended), Bulgaria (ended), France (ended), Slovakia (ongoing, recruitment ended), Greece (ended), Romania (ended).
Therapeutic area(s): Diseases [C] - Immune System Diseases [C20]
Gender: Female, Male. Age: 18-64 years, 65+ years. Enrolment: 150.
Start date (EU): 2022-08-04. Decision date: 2024-07-09. Results received: No. Last updated: 2026-05-11.
Decision dates by country: SE: 2024-07-09, HU: 2024-07-09, IT: 2024-07-15, ES: 2024-07-10, PL: 2024-07-24, SK: 2024-07-09, DE: 2024-07-10, RO: 2024-07-11, GR: 2024-07-22, FR: 2024-07-11, BG: 2024-07-12

Condition(s): Sjögren’s Syndrome
Product: Placebo to VAY736 150 mg/1 mL Solution for injection in pre-filled syringe, VAY736

Primary endpoint: The primary efficacy endpoint is change from baseline in ESSDAI score at week 48
Endpoint(s): ESSDAI response at Week 48, Low systemic disease activity (ESSDAI < 5), ESSPRI response at Week 48, Changes from baseline in sSF at Week 48, Changes from baseline in PhGA at Week 48, Changes from baseline in PaGA at Week 48, Changes from baseline in FACIT-F at Week 48, SSSD response at Week 48, Change from baseline in ESSPRI score at Week 48

Source: https://euclinicaltrials.eu/ctis-public/view/2024-511068-10-00